EU clinical trial 2024-516904-40-00: A PHASE III, MULTICENTER, RANDOMIZED, DOUBLE-BLIND, PLACEBO-CONTROLLED TRIAL COMPARING THE EFFICACY AND SAFETY OF POLATUZUMAB VEDOTIN IN COMBINATION WITH RITUXIMAB AND CHP (R-CHP) VERSUS RITUXIMAB AND CHOP (R-CHOP) IN PREVIOUSLY UNTREATED PATIENTS WITH DIFFUSE LARGE B-CELL LYMPHOMA
Protocol code: GO39942
Sponsor: F. Hoffmann-La Roche AG (Pharmaceutical company). Phase: Therapeutic confirmatory (Phase III). Countries: Belgium (ended), Poland (ended), France (ended), Germany (ended), Spain (ended), Austria (ended), Czechia (ended), Italy (ended).
Therapeutic area(s): Diseases [C] - Neoplasms [C04]
Gender: Female, Male. Age: 18-64 years, 65+ years. Enrolment: 356.
Status: Ended. Start date (EU): 2018-03-27. End date (EU): 2026-05-06. End date: 2026-05-07. Decision date: 2024-11-04. Results received: No. Last updated: 2026-04-17.
Decision dates by country: BE: 2024-11-04, CZ: 2024-11-06, DE: 2024-11-08, PL: 2024-11-16, AT: 2024-11-11, IT: 2024-11-26, ES: 2024-11-06, FR: 2024-11-04

Condition(s): Previously Untreated Diffuse large B-cell lymphoma (DLBCL)
Product: Vincristine placebo, VINCRISTINE, Polivy 140 mg powder for concentrate for solution for infusion., MabThera 500 mg concentrate for solution for infusion

Primary endpoint: 1. Progression-free survival, defined as the time from randomization to the first occurrence of disease progression or relapse as assessed by the investigator by using the Lugano Response Criteria for Malignant Lymphoma, or death from any cause, whichever occurs earlier
Endpoint(s): 1. Event-free survival (efficacy) as determined by the investigator, 2. Complete response rate at end of treatment by fluorodeoxyglucose positron emission tomography (FDG-PET) as determined by blinded independent central review (BICR), 3. Overall Survival (OS), 4. CR rate at end of treatmentby FDG-PET as determined by the investigator, 5. 2-year progression-free survival rate (PFS24) as determined by the investigator, 6. Disease-free survival (DFS), 7. Duration of response (DOR), 8. Event-free survival (all causes), 9. Time to deterioration in european organisation for research and treatment of cancer quality of life-core 30 questionnaire (EORTC QLQ-C30) physical functioning and fatigue and functional assessment of cancer therapy-lymphoma lymphoma subscale (FACT-Lym LymS), 10. Proportion of patients achieving meaningful improvement in EORTC QLQ-C30 physical functioning and fatigue, and FACT-Lym LymS, 11. EORTC QLQ-C30 rate of treatment-related symptoms and Functional Assessment of Cancer Therapy/Gynecologic Oncology Group – Neurotoxicity (FACT/GOG-NTX) peripheral neuropathy rate, 12. Incidence, nature, and severity of adverse events, with severity determined through use of national cancer institute common terminology criteria for adverse events, version 4.0 (NCI CTCAE v4.0), 13. Incidence of peripheral neuropathy rates and severity determined through use of NCI CTCAE v4.0, 14. Incidence and nature of study drug discontinuation, dose reduction, and dose delay due to adverse events, 15. Dose intensities of study drugs, 16. Plasma and/or serum concentration of polatuzumab vedotin related analytes at specified time points, 17. Incidence of anti-drug antibodies (ADAs) to polatuzumab vedotin during the study relative to the prevalence of ADAs to polatuzumab vedotin at baseline

Source: https://euclinicaltrials.eu/ctis-public/view/2024-516904-40-00